EU clinical trial 2023-504674-38-00: A study to evaluate the dose optimization measures and safety of Etentamig (ABBV-383) in subjects with Relapsed or Refractory Multiple Myeloma
Protocol code: M24-108
Sponsor: Abbvie Deutschland GmbH & Co. KG (Pharmaceutical company). Phase: Human Pharmacology (Phase I)- Other. Countries: Denmark (ongoing, recruitment ended), Spain (ongoing, recruitment ended), France (ongoing, recruitment ended).
Therapeutic area(s): Diseases [C] - Neoplasms [C04]
Gender: Female, Male. Age: 18-64 years, 65+ years. Enrolment: 45.
Status: Ongoing, recruitment ended. Start date (EU): 2023-07-31. Decision date: 2023-07-17. Results received: No. Last updated: 2026-03-11.
Decision dates by country: DK: 2023-07-17, ES: 2023-07-17, FR: 2023-07-19

Condition(s): Relapsed or Refractory Multiple Myeloma

Source: https://euclinicaltrials.eu/ctis-public/view/2023-504674-38-00